EU clinical trial 2024-516455-40-00: A Double-Blind Placebo-Controlled Randomised Phase 1b Study of the Pharmacokinetics of ALE.F02 in Patients with Advanced Liver Fibrosis and/or with Mild Cirrhosis
Protocol code: ALE.F02.02
Sponsor: Alentis Therapeutics AG (Pharmaceutical company). Phase: Human Pharmacology (Phase I)- Other. Countries: Slovakia (ended), Romania (ended).
Therapeutic area(s): Diseases [C] - Nutritional and Metabolic Diseases [C18]
Gender: Female, Male. Age: 18-64 years, 65+ years. Enrolment: 37.
Status: Ended. Start date (EU): 2023-05-25. End date (EU): 2024-10-29. End date: 2024-10-30. Decision date: 2024-10-21. Results received: No. Last updated: 2024-11-11.
Decision dates by country: RO: 2024-11-11, SK: 2024-10-21

Condition(s): Advanced liver fibrosis and/or mild liver cirrhosis

Source: https://euclinicaltrials.eu/ctis-public/view/2024-516455-40-00